EU clinical trial 2026-525163-41-00: Modafinil for debilitating fatigue in quiescent inflammatory bowel disease: a multicentre, randomised, double-blind, placebo-controlled, clinical trial (MODIFI-IBD trial)
Protocol code: 2026-525163-41-00
Sponsor: Radboud universitair medisch centrum Stichting (Hospital/Clinic/Other health care facility). Phase: Phase II and Phase III (Integrated). Countries: Netherlands (authorised, recruiting).
Therapeutic area(s): Diseases [C] - Digestive System Diseases [C06]
Gender: Female, Male. Age: 18-64 years, 65+ years. Enrolment: 60.
Status: Authorised, recruiting. Start date (EU): 2026-07-27. Decision date: 2026-05-04. Results received: No. Last updated: 2026-05-04.

Condition(s): Inflammatory bowel disease, Fatigue
Product: Modiodal 100 mg tabletten, PLACEBO

Primary endpoint: The mean difference in section I of the IBD-F questionnaire at week 8
Endpoint(s): Difference in Inflammatory Bowel Disease Questionnaire (IBDQ) comparing baseline with week 4, 8 and 12, Difference in EuroQol-5 Dimensions-5 Levels (EQ-5D-5L) comparing baseline with week 8 and 12, Difference in Pittsburgh Sleep Quality Index (PSQI) comparing baseline with week 8 and week, Difference in the Patient Health Questionnaire (PHQ-9) comparing baseline with week 4, 8 and 12, Difference in the Generalized Anxiety Disorder Questionnaire-7 (GAD-7) comparing baseline with week 4, 8 and 12, Difference in the IMTA Productivity Cost Questionnaire (iPCQ) comparing baseline with week 8 and week 12, The incidence of treatment-emergent adverse events, serious adverse events, events of clinical interest and adverse events that lead to discontinuation of modafinil use until 30 days post end of treatment, To evaluate the effect of modafinil on cognitive processes related to motivation, an exploratory endpoint will assess effort sensitivity and reward sensitivity using a validated online effort-based decision-making task, To explore the association between blood based biomarkers and their ability to identify fatigue in IBD, Difference in FACIT-F questionnaire comparing baseline with week 4, 8 and 12, Difference in section I of the IBD-F questionnaire comparing baseline with week 4 and week 12

Source: https://euclinicaltrials.eu/ctis-public/view/2026-525163-41-00